EU clinical trial 2024-516052-17-01: Evaluation of Glucocorticoids plus Rituximab Compared to Glucocorticoids Plus Placebo for the Treatment of Patients With Newly-Diagnosed or Relapsing IgA vasculitis: A Prospective, randomized, controlled, double-blind study
Sponsor: Hospital Foch (Hospital/Clinic/Other health care facility). Phase: Phase II and Phase III (Integrated). Countries: France (authorised, recruitment pending).
Therapeutic area(s): Diseases [C] - Immune System Diseases [C20]
Gender: Female, Male. Age: 18-64 years, 65+ years. Enrolment: 72.
Status: Authorised, recruitment pending. Decision date: 2024-11-28. Results received: No. Last updated: 2024-11-28.

Condition(s): Patients with a diagnosis of IgAV according to Chapel Hill Consensus Conference definitions. Patients will require having a biopsy-proven diagnosis of IgAV.
Product: MabThera 500 mg concentrate for solution for infusion, RITUXIMAB, Le placebo consiste en une perfusion de NaCl à 0.9% (500mL)., Rixathon 500 mg concentrate for solution for infusion

Primary endpoint: The proportion of patients alive who achieve remission with a prednisone dose of 0 mg/day at both days 180 and 360., The primary assessment criterion of this trial is the proportion of patients alive who achieved remission with a prednisone dose of 0 mg/day at both days 180 and 360.
Endpoint(s): Proportion of patients in remission at days 180, Proportion of patients in remission at days 360, Proportion of patients in remission both at days 180 and 360, Proportion of patients achieving remission for ≥3 consecutive months over the 360 days study period, Proportion of patients with BVAS=0 (or BVAS of ≤5 if all scores were due to persistent hematuria or proteinuria) and a prednisone dose ≤5 mg/day at days 180 and 360, Mean total accrued duration in weeks in remission of the disease (as previously defined) over the 360 days study period, Proportion of patients in complete renal and partial renal remission at days 180 and 360, Renal parameters at days 180 and 360 compared with baseline: eGFR, daily proteinuria, hematuria, arterial hypertension, use of angiotensin converting enzyme inhibitor, occurrence of end-stage renal disease, Prednisone dosage at days 180 and 360 in the two treatment groups, Area under the curve for prednisone dose at days 180 and 360 in the two treatment groups, Number of major and minor relapse at 12 months, Cumulative incidence of relapse at 12 months, Time to first IgAV relapse, Adverse events, expressed as adverse events according to the CTCAE toxicity grading system per patient-year at days 180 and 360 for the following adverse events combined: death (all causes), grade 2 or higher leukopenia or thrombocytopenia, grade 3 or higher infections, malignancies, venous thromboembolic events, hospitalization resulting either from the disease or from a complication due to the study treatment, infusion reactions (within 24 hours of infusion), The Vasculitis Damage Index at days 180 and 360 in the two treatment groups, Quality of life as measured by the HAQ and SF-36 questionnaires at days 180 and 360, The patient-reported outcomes (PRO) including patient-reported disease activity, anxiety and depression, burden of the disease and treatment and adherence to treatment, at days 180 and 360 after randomization in the two treatment groups, and during the long-term follow-up, Patient survival

Source: https://euclinicaltrials.eu/ctis-public/view/2024-516052-17-01